EU clinical trial 2024-520084-14-00: Phase I/II Study of inducible HLAG+ Regulatory T Cells (iG-Tregs) in patients undergoing HLA-matched sibling donor allogeneic haematopoietic cell transplantation.
Protocol code: IGTRegs
Sponsor: University Of Patras (Educational Institution). Phase: Phase I and Phase II (Integrated)- Other. Countries: Greece (ongoing, recruiting).
Therapeutic area(s): Diseases [C] - Virus Diseases [C02]
Gender: Female, Male. Age: 18-64 years, 65+ years. Enrolment: 26.
Status: Ongoing, recruiting. Start date (EU): 2023-05-26. Decision date: 2025-01-30. Results received: No. Last updated: 2026-03-04.

Condition(s): Adopt immunotherapy in adult patients undergoing hematopoietic stem cell (HSCT) transplantation from a fully compatible donor sibling for the prevention and treatment of GvHD.
Product: Επαγόμενα HLA-G+ Τ-ρυθμιστικά κύτταρα (iG-Tregs)

Primary endpoint: To define the safety, tolerability, and maximum tolerable dose (MTD) of iG-Tregs for GvHD prophylaxis (Time frame: until 90 days following the infusion): - Incidence of infusion toxicity (within 1 hour of the infusion and graded according to CTCAE v. 4), Additional toxicities that may occur related to iG-Treg infusion (eg. Occurrence of exacerbation of GvHD, infections, disease relapse), Adverse effects occurring during the first 3 weeks following iG- Treg infusion will be accounted for the assessment of the safety profile and tolerability of each dose during the dose escalation phase (dose limiting toxicities, DLTs). One iG-Treg dose will be considered safe if DLT occurs only in 1/6 or 0/3 subjects of each cohort.
Endpoint(s): Clinical efficacy of iG-Treg infusion in GvHD prophylaxis (Time frame: 52 weeks following allo-HCT): 1. Incidence and severity of GvHD, Day of cyclosporine (CsA) cessation, Treatment failure (includes the diagnosis GvHD, inability to cease CsA administration until d+150 following allo-HCT, disease relapse), Patients receiving iG-Tregs will be compared to a cohort not receiving the infusion of with retrospective data.

Source: https://euclinicaltrials.eu/ctis-public/view/2024-520084-14-00